EU clinical trial 2023-506648-18-00: CASPER-ATG-IPC 2023-015 : Reinforced prophylaxis of GVH in elderly patients with haematological malignancies receiving haploidentical allogeneic hematopoietic stem cell transplantation: use of a low dose of post-allograft anti-lymphocytic serum.
Sponsor: Institut Paoli-Calmettes (Hospital/Clinic/Other health care facility). Phase: Therapeutic exploratory (Phase II). Countries: France (ongoing, recruiting).
Therapeutic area(s): Diseases [C] - Neoplasms [C04]
Gender: Female, Male. Age: 18-64 years, 65+ years. Enrolment: 27.
Status: Ongoing, recruiting. Start date (EU): 2025-01-14. Decision date: 2024-06-27. Results received: No. Last updated: 2026-05-20.

Condition(s): haematological malignancies
Product: THYMOGLOBULINE 5 mg/ml, poudre pour solution pour perfusion

Primary endpoint: Evaluate the rate of grade 2-4 acute GVH at D100 post allograft using the MAGIC7 classification.
Endpoint(s): Grade 2-4 acute GVH will be assessed using the MAGIC7 classification at D30, D60, D90, D100, D120, D180, D270 and at D365 post allograft, Chronic GVH will be assessed using NIH8 classification at D100, D120, D180, D270 and at D365 post allograft, Cumulative incidence of chronic GVH at 1 year post-transplant, Cumulative incidence of non-relapse mortality (NRM) at 1 year post-transplant, Cumulative incidence of relapse at 1 year post-transplant, Blood T, B and NK lymphocyte counts at D30, D60, D90, D120 and D180 post-transplant, Cumulative incidence of invasive fungal and viral infections (CMV, EBV, BK virus) between D30 and D120 post allograft, Cumulative incidence of EBMT-defined "poor graft function" at D100 post-transplant, Progression-free survival at 1 year post-transplant, Overall survival at 1 year post-transplant, Quality of life: assessed using the Functional Assessment of Cancer Therapy-Bone Marrow Transplant (FACT-BMT) questionnaire.

Source: https://euclinicaltrials.eu/ctis-public/view/2023-506648-18-00